EU clinical trial 2024-513392-40-01: MIRROR; Multispectral and bimodal fluorescent guided surgery (FGS) of high-grade glioma for refining margin assessment: A phase 1 dose finding study using Cetuximab-IRDye800CW- combined with 5-ALA
Protocol code: NC2022-01
Sponsor: Universitair Medisch Centrum Groningen (Hospital/Clinic/Other health care facility). Phase: Human Pharmacology (Phase I)- First administration to humans. Countries: Netherlands (ongoing, recruiting).
Therapeutic area(s): Diseases [C] - Neoplasms [C04]
Gender: Female, Male. Age: 18-64 years, 65+ years. Enrolment: 21.
Status: Ongoing, recruiting. Start date (EU): 2023-03-31. Decision date: 2024-09-03. Results received: No. Last updated: 2024-09-03.

Condition(s): Glioblastoma

Source: https://euclinicaltrials.eu/ctis-public/view/2024-513392-40-01